EU clinical trial 2025-521227-70-00: A First-In-Human, phase I/IIa, open-label trial assessing safety, tolerability, and feasibility of repeated administrations of a novel autologous tumor-infiltrating lymphocyte-based immunotherapy in patients with metastatic colorectal or prostate cancer
Protocol code: ProbeTILity
Sponsor: CuraCell Holding AB (Pharmaceutical company). Phase: Phase I and Phase II (Integrated)- First administration to humans. Countries: Germany (ongoing, recruiting).
Therapeutic area(s): Diseases [C] - Male Urogenital Diseases [C12]; Diseases [C] - Digestive System Diseases [C06]
Gender: Female, Male. Age: 18-64 years, 65+ years. Enrolment: 12.
Status: Ongoing, recruiting. Start date (EU): 2025-11-13. Decision date: 2025-07-29. Results received: No. Last updated: 2026-06-01.

Condition(s): Patients with locally advanced or metastatic prostate cancer (PCa) or metastatic colorectal cancer. Participants should have progressive disease.
Product: KEYTRUDA 25 mg/mL concentrate for solution for infusion, Proleukin® S 18 x 10 6 IE Pulver zur Herstellung einer Injektionslösung oder Infusionslösung, Uromitexan Tabletten 400 mg, Cyclophosphamid HEXAL 500 mg Pulver zur Herstellung einer Injektions-/Infusionslösung

Primary endpoint: Incidence of treatment emergent adverse events (TEAE) and the occurrence of severity grade 3 or higher adverse events according to NCI CTCAE v5.0; Proportion of patients receiving at least two TIL administrations without TEAEs preventing TIL administration
Endpoint(s): Measurable objective response rate, defined as proportion of patients with complete [CR] or partial response [PR] as best response to treatment within the first 6 months after start of CC-38 administration, as assessed by the Investigator according to RECIST 1.1 and iRECIST (ORR/ iORR), Progression-free survival, defined as the time from start of treatment to time of disease progression, as assessed by the Investigator according to RECIST 1.1 and iRECIST (PFS/ iPFS), or death from any cause, whichever comes first, Time to tumor progression, defined as time from start of treatment to disease progression as assessed by the Investigator according to RECIST 1.1 and iRECIST (TTP/ iTTP), Overall survival (OS), defined as time from start of treatment to time of death from any cause, For prostate cancer cohort: Patient individual changes in prostate-specific antigen (PSA) levels from baseline until 6 months after start of treatment; in addition, changes in tumor spread will be assessed by PSMA PET-CT at baseline and after third CC-38 administration, For colorectal cancer cohort: Patient individual changes in biomarkers (including elevated tumor markers, i.e., carcinoembryonic antigen [CEA] and cancer antigen 19-9 [CA-19-9] levels) from baseline until 6 months after start of treatment

Source: https://euclinicaltrials.eu/ctis-public/view/2025-521227-70-00